EU clinical trial 2023-509905-62-00: RIVACAST - RIVAroxaban versus low-molecular weight heparin in patients with lower limb trauma requiring brace or CASTing
Protocol code: 49RC21_0376
Sponsor: Centre Hospitalier Universitaire D'Angers (Hospital/Clinic/Other health care facility). Phase: Therapeutic confirmatory (Phase III). Countries: France (ongoing, recruiting).
Therapeutic area(s): Diseases [C] - Cardiovascular Diseases [C14]; Diseases [C] - Musculoskeletal Diseases [C05]
Gender: Female, Male. Age: 18-64 years, 65+ years. Enrolment: 1424.
Status: Ongoing, recruiting. Start date (EU): 2024-07-19. Decision date: 2024-04-12. Results received: No. Last updated: 2026-06-17.

Condition(s): Lower limb trauma requiring immobilisation
Product: FRAXIPARINE 5 700 U.I. Axa/0,6 ml, solution injectable (S.C.) en seringue pré-remplie, FRAGMINE 5 000 U.l. anti Xa/0,2 mL, solution injectable en seringue pré-remplie, RIVAROXABAN EG 10 mg, comprimé pelliculé, Inhixa 4,000 IU (40 mg)/0.4 mL solution for injection in pre-filled syringe, FRAXIPARINE 3 800 U.I. Axa/0,4 ml, solution injectable (S.C.) en seringue pré-remplie, LOVENOX 4 000 UI (40 mg)/0,4 ml, solution injectable en seringue préremplie, INNOHEP 4 500 UI anti-Xa/0,45 ml, solution injectable en seringue préremplie, Xarelto 10 mg film-coated tablets, FRAGMINE 2 500 U.l. anti Xa/0,2 mL, solution injectable en seringue pré-remplie

Primary endpoint: The primary endpoint is the rate of symptomatic venous thromboembolic events (i.e., deep venous thrombosis and/or pulmonary embolism and/or death due to pulmonary embolism) within the 45 days after the inclusion

Source: https://euclinicaltrials.eu/ctis-public/view/2023-509905-62-00